EU clinical trial 2024-516526-66-00: Phase 1 Study of JNJ-89402638 for Metastatic Colorectal and Gastric Cancer
Protocol code: 89402638GIC1001
Sponsor: Janssen Cilag International (Pharmaceutical company). Phase: Human Pharmacology (Phase I)- First administration to humans. Countries: Spain (ongoing, recruiting).
Therapeutic area(s): Diseases [C] - Neoplasms [C04]
Gender: Female, Male. Age: 18-64 years, 65+ years. Enrolment: 80.
Status: Ongoing, recruiting. Start date (EU): 2025-01-21. Decision date: 2024-12-11. Results received: No. Last updated: 2026-04-27.

Condition(s): Metastatic colorectal cancer and Gastric cancer

Source: https://euclinicaltrials.eu/ctis-public/view/2024-516526-66-00